EU clinical trial 2023-509489-39-00: CIRSARC : PHASE III TRIAL INVESTIGATING BENEFIT OF INTENSIFIED PERI-OPERATIVE CHEMOTHERAPY WITHIN HIGH-RISK CINSARC PATIENTS WITH RESECTABLE SOFT-TISSUE SARCOMAS
Protocol code: IB2017-04
Sponsor: Institut Bergonie (Hospital/Clinic/Other health care facility). Phase: Therapeutic confirmatory (Phase III). Countries: France (ongoing, recruiting).
Therapeutic area(s): Diseases [C] - Neoplasms [C04]
Gender: Female, Male. Age: 18-64 years, 65+ years. Enrolment: 351.
Status: Ongoing, recruiting. Start date (EU): 2019-02-05. Decision date: 2024-02-06. Results received: No. Last updated: 2026-02-23.

Condition(s): Resectable, non-metastatic soft-tissue sarcoma (STS)
Product: HOLOXAN 2000 mg, poudre pour usage parentéral, DETICENE 100 mg, poudre et solvant pour solution pour perfusion, DOXORUBICINE ACCORD 2 mg/ml, solution pour perfusion

Primary endpoint: Metastasis progression-free survival (M-PFS) is defined as the time interval between the randomization date and the date of death (whatever the cause), or distant progression, whichever occurs first (DATECAN guidelines, Bellera et al. Annals Oncol 2014).
Endpoint(s): Loco-regional relapse-free survival (LR-RFS) is defined as the time interval between the randomization date and the date of death (whatever the cause), or loco-regional progression, whichever occurs first (DATECAN guidelines, Bellera et al. Annals Oncol 2015). Progression-free survival is defined as the time interval between the randomization date and the date of death (whatever the cause) or progression (as per RECIST v1.1), whichever occurs first., Overall survival is defined as the time interval between the randomization date and the date of death (whatever the cause)., Best overall response is defined as the best response recorded from randomization until the end of neoadjuvant chemotherapy taking into account any requirement for confirmation as per RECIST v1.1 criteria, Histological response is defined based on tumour sample as the average proportion of recognizable cells on the tumour sample [Huvos et al, Arch Pathol Lab Med 1977]. Good histological response is defined as <10% viable cells on the tumour sample., Safety will be described using the common toxicity criteria from the NCI v5.

Source: https://euclinicaltrials.eu/ctis-public/view/2023-509489-39-00